EU clinical trial 2024-518526-33-01: PEMBROLIZUMAB IN MMR-PROFICIENT METASTATIC COLORECTAL CANCER PHARMACOLOGICALLY PRIMED TO TRIGGER DYNAMIC HYPERMUTATION STATUS - THE ARETHUSA TRIAL
Protocol code: CPT002/2018/PO001
Sponsor: Ifom Istituto Fondazione Di Oncologia Molecolare Ets In Breve Ifom Ets (Laboratory/Research/Testing facility). Phase: Therapeutic exploratory (Phase II). Countries: Italy (ended).
Therapeutic area(s): Diseases [C] - Neoplasms [C04]
Gender: Female, Male. Age: 18-64 years, 65+ years. Enrolment: 822.
Status: Ended. Start date (EU): 2025-01-09. End date (EU): 2025-01-09. Decision date: 2025-01-09. Results received: No. Last updated: 2025-01-09.

Condition(s): Metastatic colorectal cancer
Product: KEYTRUDA 25 mg/mL concentrate for solution for infusion, TEMOZOLOMIDE, TEMOZOLOMIDE

Primary endpoint: To assess the objective response rate of pembrolizumab in metastatic MMR proficient, extended RAS mutated CRC patients who have failed standard therapies, with MGMT-negative tumors treated with TMZ, given with the intent of increasing the mutational load of their tumors (cohort P).
Endpoint(s): To assess the objective response rate in MMR deficient patients (cohort D) identified during the MMR screening., To assess the Progression Free Survival (PFS) and Overall Survival (OS) both P and D cohorts patients., To assess the safety and tolerability of pembrolizumab after TMZ-priming therapy (cohort P)., To assess the safety and tolerability of pembrolizumab (cohort D).

Source: https://euclinicaltrials.eu/ctis-public/view/2024-518526-33-01